EU clinical trial 2023-507497-40-00: A Study Evaluating the Safety, Efficacy and Pharmacokinetics of Venetoclax in Combination With Polatuzumab Vedotin Plus Rituximab (R) and Cyclophosphamide, Doxorubicin, Prednisone (CHP) in Participants With Untreated BCL-2 Immunohistochemistry (IHC)-Positive Diffuse Large B-Cell Lymphoma (DLBCL)
Protocol code: BO42203
Sponsor: F. Hoffmann-La Roche AG (Pharmaceutical company). Phase: Human Pharmacology (Phase I)- First administration to humans. Countries: Spain (ended), France (ended), Italy (ended).
Therapeutic area(s): Diseases [C] - Neoplasms [C04]
Gender: Female, Male. Age: 18-64 years, 65+ years. Enrolment: 36.
Status: Ended. Start date (EU): 2021-05-31. End date (EU): 2024-05-13. End date: 2024-05-22. Decision date: 2024-03-07. Results received: No. Last updated: 2024-05-16.
Decision dates by country: FR: 2024-03-11, IT: 2024-03-11, ES: 2024-03-07

Condition(s): Diffuse large B-cell lymphoma (DLBCL), Grade 3B follicular lymphoma, High grade B-cell lymphoma (HGBL), Epstein-Barr virus−positive DLBCL

Source: https://euclinicaltrials.eu/ctis-public/view/2023-507497-40-00